EU clinical trial 2025-523913-27-00: PACHA-02_Postoperative hepatic arterial chemotherapy after resection of colorectal liver metastases in patients at high risk of recurrence
Protocol code: UC-GIG-2515
Sponsor: Unicancer (Hospital/Clinic/Other health care facility). Phase: Therapeutic confirmatory (Phase III). Countries: France (authorised, recruitment pending).
Therapeutic area(s): Diseases [C] - Neoplasms [C04]
Gender: Female, Male. Age: 18-64 years, 65+ years. Enrolment: 272.
Status: Authorised, recruitment pending. Decision date: 2026-06-05. Results received: No. Last updated: 2026-06-05.

Condition(s): Participants with R0/R1 resected liver metastases from colorectal cancer (CRLM).
Product: FLUOROURACIL, FOLINIC ACID, OXALIPLATIN, OXALIPLATIN, CALCIUM LEVOFOLINATE, IRINOTECAN

Primary endpoint: The primary endpoint is the progression-free survival (PFS), defined as the time between randomization and the occurrence of the first oncological event observed according to RECIST v1.1 criteria, such as local or metastatic recurrence, progression or death from any cause.
Endpoint(s): Overall survival (OS), defined as the time from randomization to death, irrespective of cause. Patients still alive at the time of the analysis will be censored at the date of last follow-up., Hepatic recurrence-free survival (h-RFS), defined as the time from randomization to the occurrence of the first hepatic relapse according to RECIST v1.1 criteria or death from any cause. Patients alive without hepatic recurrence at the time of the analysis will be censored at the date of last follow-up., Patterns of progression or recurrence, defined as hepatic recurrence rate and extra hepatic recurrence or progression rate as first oncological event., Feasibility, defined as: - Proportion of patients receiving at least 4 cycles of oxaliplatin arm. - Relative dose-intensity of oxaliplatin (calculated over the first three months of treatment)., Safety assessed according to Common Terminology Criteria for Adverse Events (CTCAE v5.0) system for treatment toxicity. In HAI arm catheter-related complications and treatment procedures will be analyzed. AE will be coded with the MedDRA dictionary., Type of chemotherapy (IV, HAI, lines and cycles) and rate of curative intent treatments (surgery, local ablation or radiotherapy) in case of recurrence, Tumor response rate according to RECIST v1.1 criteria following reintroduction of chemotherapy in case of recurrence, Health-related Quality of life evaluated with European Organization for Research and Treatment of Cancer (EORTC) core quality of life questionnaire (QLQ) EORTC QLQ-C30 associated with the Liver colorectal metastasis Module QLQ-LMC21

Source: https://euclinicaltrials.eu/ctis-public/view/2025-523913-27-00